EU clinical trial 2024-514292-18-00: An Open-label study of patients with primary sclerosing cholangitis (PSC) treated with norucholic acid tablets
Protocol code: NUT-022/PSC
Sponsor: Dr. Falk Pharma GmbH (Pharmaceutical company). Phase: Therapeutic confirmatory (Phase III). Countries: Germany (ongoing, recruitment ended), Netherlands (ongoing, recruitment ended), Belgium (ongoing, recruitment ended), France (ongoing, recruitment ended), Norway (ongoing, recruitment ended), Austria (ongoing, recruitment ended), Sweden (ongoing, recruitment ended), Hungary (ongoing, recruitment ended), Poland (ongoing, recruitment ended), Denmark (ongoing, recruitment ended).
Therapeutic area(s): Diseases [C] - Digestive System Diseases [C06]
Gender: Female, Male. Age: 18-64 years, 65+ years. Enrolment: 79.
Status: Ongoing, recruitment ended. Start date (EU): 2025-03-24. Decision date: 2025-03-10. Results received: No. Last updated: 2025-08-25.
Decision dates by country: DE: 2025-03-11, FR: 2025-03-14, SE: 2025-03-17, AT: 2025-03-21, NL: 2025-03-20, NO: 2025-03-12, HU: 2025-03-19, DK: 2025-03-17, BE: 2025-03-10, PL: 2025-03-24

Condition(s): Primary Sclerosing Cholangitis (PSC)
Product: NUT01

Primary endpoint: Occurrence of Treatment emergent adverse events (TEAEs), Occurrence of Serious TEAEs, Occurrence of Severe TEAEs, Occurrence of Adverse Drug reactions (ADRs), Occurrence of Unexpected TEAEs
Endpoint(s): (Safety) Changes from baseline in vital signs (blood pressure, heart rate) and body weight, (Safety) Changes from baseline in hematology, serum chemistry (other than efficacy variables) and urinalysis, (Efficacy) Course of liver stiffness, (Efficacy) s-ALP in categories from baseline to EoT

Source: https://euclinicaltrials.eu/ctis-public/view/2024-514292-18-00